EU clinical trial 2024-514053-30-00: Sequential immunochemotherapy treatment with Pembrolizumab plus Dendritic Cell (DC) Vaccine followed by Trifluridine/Tipiracil plus Bevacizumab in refractory mismatch-repair-proficient (pMMR) or microsatellite-stable (MSS) metastatic colorectal cancer
Protocol code: IRST153.09
Sponsor: Istituto Romagnolo Per Lo Studio Dei Tumori Dino Amadori IRST S.r.l. (Hospital/Clinic/Other health care facility). Phase: Therapeutic exploratory (Phase II). Countries: Italy (ongoing, recruiting).
Therapeutic area(s): Diseases [C] - Neoplasms [C04]
Gender: Female, Male. Age: 18-64 years, 65+ years. Enrolment: 36.
Status: Ongoing, recruiting. Start date (EU): 2025-01-07. Decision date: 2024-11-07. Results received: No. Last updated: 2026-04-27.

Condition(s): Metastatic colorectal cancer
Product: BEVACIZUMAB, DC-VACCINE_IRSTIRCCS, Lonsurf 20 mg/8.19 mg film-coated tablets, VEGZELMA 25 mg/mL concentrate for solution for infusion, VEGZELMA 25 mg/mL concentrate for solution for infusion, Lonsurf 15 mg/6.14 mg film-coated tablets, KEYTRUDA 25 mg/mL concentrate for solution for infusion, BEVACIZUMAB

Primary endpoint: The primary endpoint is Overall Response Rate (ORR) of chemotherapy, defined as the percentage of patients experiencing partial response (PR) or complete response (CR), according to Response Evaluation Criteria in Solid Tumors (RECIST) version 1.1, after starting the treatment with the first immunotherapy induction administration.
Endpoint(s): Progression free survival (PFS): measured as the time from the date of the first immunotherapy induction administration to the date of first progression, or the date of death from any cause, or the date of the last restaging in non-progressed patients, Safety evaluation: all adverse events will be recorded during the observation period (i.e. from the day of the first DC vaccine dose administered in the induction phase up to 30 days after the last dose of chemotherapy), will be reported and graded according to NCI CTCAE 5.0, Overall Survival (OS): measured from the start of the induction treatment until the date of death from any cause or the last date on which it was known that the patient was alive, In vivo immunomonitoring through DTH test; characterization of patient's HLA class I and II and HLA-restricted immune response and definition of the prognostic and predictive role of peripheral immune cell subsets and soluble factors, In situ characterization of MSS/pMMR mCRC through NGS and in situ protein validation at the single cell level

Source: https://euclinicaltrials.eu/ctis-public/view/2024-514053-30-00